EU clinical trial 2023-509418-12-00: A multicentre controlled, randomised, single-blind adaptive phase IV protocol to evaluate efficacy, safety and cost-efficacy of pre-emptive genotyping strategy in a population at risk of cardiovascular disease susceptible of receiving high or moderate-intensity doses of statins
Protocol code: PREVESTATGx
Sponsor: Fundacion Para La Investigacion Biomedica Del Hospital Universitario La Paz (Patient organisation/association). Phase: Therapeutic use (Phase IV). Countries: Spain (ongoing, recruitment ended).
Therapeutic area(s): Diseases [C] - Cardiovascular Diseases [C14]
Gender: Female, Male. Age: 18-64 years, 65+ years. Enrolment: 216.
Status: Ongoing, recruitment ended. Start date (EU): 2024-06-05. Decision date: 2024-05-21. Results received: No. Last updated: 2025-11-13.

Condition(s): Patients at risk of cardiovascular disease susceptible of receiving high or moderate-intensity doses of statins.
Product: Rosuvastatina ratiopharm 20 mg comprimidos recubiertos con pelicula EFG, Pravastatina Cinfamed 40 mg comprimidos EFG, pitavastatina cinfa 2 mg comprimidos recubiertos con película EFG, simvastatina cinfa 20 mg comprimidos recubiertos con película EFG, Fluvastatina ratiopharm 80 mg comprimidos de liberación prolongada EFG., lovastatina cinfa 40 mg comprimidos EFG, Atorvastatina NORMON 40 mg comprimidos recubiertos con película EFG

Primary endpoint: A composite variable that includes the incidence of patients with a clinically relevant statin-associated musculoskeletal symptom (defined as a combination of a SAMS-CI score ≥7 and a NPRS score ≥3) in the 9-month follow-up period or a serum CPK greater than three times the upper limit of normality prespecified by each centre’s laboratory, related to the statin.
Endpoint(s): 9-month change in percentual LDLc defined as the percentage difference between LDLc values at 9 months minus baseline LDLc., Percentage of patients that require either a statin dose modification/withdrawal or additional lipid-lowering therapy after 9 months in order to meet LDLc goals., The difference between the costs of the intervention and all its surrounding procedures combined with the costs derived from the events in the intervention arm when compared to the costs derived from the events in the control arm alone over the 9-month follow-up period. Additionally, the ratio between cost differences and efficacy differences between both arms may be calculated., Novel prognostic and predictive genetic biomarkers of statin-related adverse events and efficacy will be assessed in outlier subject’s/or any given subject for quality control reasons trough techniques not readily available at all centres, and only available at CNIO as well as genome-wide association studies when applicable. Aforementioned techniques may vary at CNIOs criteria and may include (but are not limited to) assays and/or next generation sequencing techniques., Percentage of participants who experience a 4-component exploratory endpoint consisting of cardiovascular death, nonfatal myocardial infarction (MI), resuscitated cardiac arrest, or hospitalization for unstable angina, Difference in Morisky-Green (MMAS-8) questionnaire adherence levels/score between both study arms., Difference in Numeric Pain Rating Scale (NPRS) score between both study arms. Categories will be as follow: 0-3 no pain; 3-5 moderate pain; 5-7 intense pain; 7-9 very intense pain; 9-10 extreme pain.

Source: https://euclinicaltrials.eu/ctis-public/view/2023-509418-12-00